EU clinical trial 2024-517209-95-00: A study to test how different doses of BI 3731579 are tolerated by healthy people
Protocol code: 1519-0002
Sponsor: Boehringer Ingelheim International GmbH (Pharmaceutical company). Phase: Human Pharmacology (Phase I)- Other. Countries: Belgium (ended).
Therapeutic area(s): Not possible to specify
Gender: Female, Male. Age: 18-64 years. Enrolment: 40.
Status: Ended. Start date (EU): 2024-12-11. End date (EU): 2025-06-23. Decision date: 2024-11-19. Results received: No. Last updated: 2025-02-14.

Condition(s): Healthy volunteer trial

Source: https://euclinicaltrials.eu/ctis-public/view/2024-517209-95-00